EU clinical trial 2024-519160-41-00: Scar Remodeling after Burn Injury using Adipose-derived Allogeneic Stem Cells (ScarASC)
Sponsor: Copenhagen University Hospital (Hospital/Clinic/Other health care facility). Phase: Phase I and Phase II (Integrated)- Other. Countries: Denmark (authorised, recruitment pending).
Therapeutic area(s): Diseases [C] - Skin and Connective Tissue Diseases [C17]
Gender: Female, Male. Age: 18-64 years, 65+ years. Enrolment: 39.
Status: Authorised, recruitment pending. Decision date: 2025-04-11. Results received: No. Last updated: 2026-04-17.

Condition(s): Hypertrophic scarring.
Product: CryoStor CS10 + Physiologic solution, e.g., Ringers Lactate, Culture expanded Adipose Derived Regenerative Cells, ADRC001

Primary endpoint: Change in total patient score of the Danish Patient and Observer Scar Assessment Scale version 3.0.
Endpoint(s): Change in total observer score of the Danish Patient and Observer Scar Assessment Scale version 3.0., Scar volume and microstructure measured by three-dimensional photography, measured in nano cubic meter., Scar elevation index / scar thickness by ultrasound video sequencing, measured as a ratio and in milli meter., Changes in collagen fiber arrangement., Up- and/or downregulation of biomarkers from punch biopsies., Development of de novo HLA., Histologic assessment of the presence of donor stem cells / DNA., Safety assessment by documenting any adverse events or suspected unexpected serious adverse reactions at every follow-up.

Source: https://euclinicaltrials.eu/ctis-public/view/2024-519160-41-00